EU clinical trial 2022-500953-17-00: A Phase 2b, Randomized, Double-blind, Placebo-controlled Study to Evaluate the Safety and Efficacy of 3 Active Dose Regimens of MORF-057 in Adults with Moderately to Severely Active Ulcerative Colitis (EMERALD-2)
Protocol code: MORF-057-202
Sponsor: Morphic Therapeutic Inc. (Pharmaceutical company). Phase: Therapeutic exploratory (Phase II). Countries: Italy (ended), Hungary (ended), Latvia (ended), France (ended), Bulgaria (ended), Czechia (ended), Estonia (ended), Lithuania (ended), Austria (ongoing, recruitment ended), Germany (ended), Slovakia (ended), Poland (ongoing, recruitment ended), Romania (ended).
Therapeutic area(s): Diseases [C] - Digestive System Diseases [C06]
Gender: Female, Male. Age: 18-64 years, 65+ years. Enrolment: 172.
Start date (EU): 2023-03-23. Decision date: 2023-02-03. Results received: No. Last updated: 2026-03-16.
Decision dates by country: FR: 2023-05-29, LT: 2023-03-21, IT: 2023-05-22, RO: 2023-02-06, AT: 2023-02-06, BG: 2023-02-06, CZ: 2023-02-03, PL: 2023-02-06, LV: 2023-02-06, EE: 2023-02-06, SK: 2023-02-06, DE: 2023-02-03, HU: 2023-02-03

Condition(s): Moderately to severely active ulcerative colitis
Product: MORF-057 IR Capsule, Placebo for MORF-057, capsule, unauthorised

Primary endpoint: Primary Efficacy: Proportion of participants in clinical remission at Week 12 as determined using the Modified Mayo Clinic Score (mMCS). The mMCS is a composite of the following subscores: - Mayo endoscopic subscore (MES) - Mayo Clinic Score (MCS) stool frequency subscore - MCS rectal bleeding subscore
Endpoint(s): Secondary Efficacy: Proportion of participants with clinical response at Week 12 as determined using the mMCS, Exploratory Efficacy: Proportion of participants in clinical remission at Week 52 as determined using the mMCS, Exploratory Efficacy: Proportion of participants with clinical response at Week 52 as determined using the mMCS, Exploratory Efficacy: Proportion of participants in MCS remission at Weeks 12 and 52. MCS is a composite of the following subscores: MES; MCS stool frequency subscore ; MCS rectal bleeding subscore; MCS Physician’s Global Assessment (PGA), Exploratory Efficacy: Proportion of participants with MCS response at Weeks 12 and 52, Exploratory Efficacy: - Proportion of participants in histologic remission at Weeks 12 and 52 as determined using the Robarts Histopathology Index (RHI) Score - Proportion of participants in histologic remission at Weeks 12 and 52 as determined using the Nancy Histopathology Index (NI) - Proportion of participants in histologic remission at Weeks 12 and 52 as determined using the Continuous Geboes Score, Exploratory Efficacy: Proportion of participants with histologic improvement at Weeks 12 and 52 as determined using the RHI, Exploratory Efficacy: Proportion of participants with endoscopic improvement at Weeks 12 and 52 as determined using the MES, Exploratory Efficacy: Proportion of participants in endoscopic remission at Weeks 12 and 52 as determined using the MES, Exploratory Efficacy: Proportion of participants in endoscopic remission as determined using the MES and histologic remission as determined using the RHI at Weeks 12 and 52, Exploratory Efficacy: Proportion of participants with endoscopic improvement as determined using the MES and a histologic improvement as determined using the RHI at Weeks 12 and 52, Exploratory Efficacy: Proportion of participants with symptomatic response at Weeks 2 and 6 as determined using the Partial mMCS. Partial mMCS is a composite of the following subscores:MCS stool frequency subscore; MCS rectal bleeding subscore, Exploratory Efficacy: Proportion of participants with Partial MCS response at Week 6. Partial MCS is a composite of the following subscores: MCS stool frequency subscore; MCS rectal bleeding subscore; MCS PGA, Exploratory Efficacy: Time to symptomatic response by Week 12 as determined using the Partial mMCS, Exploratory Efficacy: - Change from baseline to Weeks 12 and 52 in high sensitivity C reactive protein (hs CRP) levels - Change from baseline to Weeks 12 and 52 in fecal calprotectin levels, Exploratory Efficacy: Change from baseline to Weeks 12 and 52 in Inflammatory Bowel Disease Questionnaire (IBDQ) Score, Exploratory Efficacy: Proportion of participants in corticosteroid free remission at Week 52, as determined using the mMCS, among the participants who were on a stable dose of corticosteroids at baseline, Exploratory Efficacy: Percentage of participants requiring UC related hospitalization or surgery at Weeks 12 and 52, Exploratory Efficacy: • Proportion of participants in histologic remission at Week 104 as determined using the RHI • Proportion of participants in histologic remission at Week 104 as determined using the NI • Proportion of participants in histologic remission at Week 104 as determined using the Continuous Geboes Score • Proportion of participants with histologic improvement at Week 104 as determined using the RHI, Exploratory Efficacy: • Proportion of participants with endoscopic improvement at Week 104 as determined using MES • Proportion of participants in endoscopic remission at Week 104 as determined using MES • Proportion of participants in endoscopic remission as determined using MES and histologic remission as determined using RHI at Week 104 • Proportion of participants with endoscopic improvement as determined using MES and a histologic improvement as determined using RHI at Week 104, Safety: Frequencies and proportions for treatment emergent serious adverse events (TESAEs), and TEAEs leading to study drug discontinuation., Pharmacokinetics: MORF-057 concentration in plasma, Exploratory Pharmacodynamics: - α4β7 receptor occupancy in blood over time - α4β1 receptor occupancy in blood over time - Change from baseline over time in blood CCR9 messenger ribonucleic acid (mRNA) - Change from baseline over time in blood lymphocyte subsets

Source: https://euclinicaltrials.eu/ctis-public/view/2022-500953-17-00